EU clinical trial 2024-517943-29-00: A Phase 3, Multicenter, Randomized, Double-Blinded, Placebo-Controlled Study to Evaluate the Safety and Efficacy of L606 (Treprostinil Liposome Inhalation Suspension) in Participants with Pulmonary Hypertension Associated with Interstitial Lung Disease (WHO Group 3)
Protocol code: L606-301
Sponsor: Liquidia Technologies Inc. (Pharmaceutical company). Phase: Therapeutic confirmatory (Phase III). Countries: Latvia (ongoing, recruiting), Germany (ongoing, recruiting), Italy (authorised, recruiting), Czechia (authorised, recruitment pending), France (authorised, recruiting), Belgium (authorised, recruiting), Portugal (ongoing, recruiting), Poland (authorised, recruitment pending), Austria (authorised, recruiting), Spain (authorised, recruiting).
Therapeutic area(s): Diseases [C] - Respiratory Tract Diseases [C08]
Gender: Female, Male. Age: 18-64 years, 65+ years. Enrolment: 121.
Start date (EU): 2026-04-21. Decision date: 2026-03-11. Results received: No. Last updated: 2026-03-23.
Decision dates by country: AT: 2026-03-22, BE: 2026-03-11, CZ: 2026-03-13, FR: 2026-03-17, DE: 2026-03-18, IT: 2026-03-20, LV: 2026-03-18, PT: 2026-03-13, ES: 2026-03-18, PL: 2026-03-23

Condition(s): Pulmonary Hypertension associated with interstitial lung disease (WHO Group 3)
Product: Treprostinil Liposome, Treprostinil Liposome, Treprostinil Liposome, Treprostinil Liposome, Treprostinil Liposome, L606 Placebo Inhalation Suspension, Treprostinil Liposome

Primary endpoint: Change from Baseline to Week 16 in 6-minute walk distance (6MWD)
Endpoint(s): Time to first occurrence of 1 of the following clinical worsening event (CWE) criterion are met: -Death (all causes) -Hospitalization due to a cardio-pulmonary indication related to underlying disease -Lung transplant -Decrease in 6MWD > 15% from Baseline related to disease under study, at 2 consecutive visits and at least 1 week apart, Change from Baseline to Week 24 in 6-Minute Walk Distance (6MWD), Change from Baseline to Week 16 in 6MWD

Source: https://euclinicaltrials.eu/ctis-public/view/2024-517943-29-00